EU clinical trial 2024-520190-12-00: A Phase 3, Randomized, Open-label Study to Evaluate the Efficacy and Safety of Sac-TMT (Sacituzumab Tirumotecan, MK-2870) Followed by Carboplatin/Paclitaxel vs Chemotherapy, Both in Combination With Pembrolizumab as Neoadjuvant Therapy for High-Risk Early-Stage Triple-Negative Breast Cancer (TNBC) or Hormone Receptor-low positive/HER2-negative Breast Cancer
Protocol code: MK-2870-032
Sponsor: Merck Sharp & Dohme LLC (Pharmaceutical company). Phase: Therapeutic confirmatory (Phase III). Countries: France (ongoing, recruiting), Sweden (ongoing, recruiting), Poland (ongoing, recruiting), Spain (ongoing, recruiting), Finland (ongoing, recruiting), Portugal (ongoing, recruiting), Belgium (ongoing, recruiting), Czechia (ongoing, recruiting), Germany (ongoing, recruiting), Greece (ongoing, recruiting), Hungary (ongoing, recruiting), Italy (ongoing, recruiting), Romania (ongoing, recruiting), Norway (ongoing, recruiting).
Therapeutic area(s): Diseases [C] - Neoplasms [C04]
Gender: Female, Male. Age: 18-64 years, 65+ years. Enrolment: 598.
Status: Ongoing, recruiting. Start date (EU): 2025-11-10. Decision date: 2025-08-27. Results received: No. Last updated: 2026-06-22.
Decision dates by country: GR: 2026-01-19, BE: 2025-11-10, RO: 2026-02-23, CZ: 2026-02-17, IT: 2026-01-28, PL: 2025-09-01, NO: 2026-02-11, FR: 2025-09-01, ES: 2025-08-28, FI: 2025-11-11, HU: 2026-01-14, DE: 2026-02-17, PT: 2025-11-07, SE: 2025-09-01

Condition(s): Breast Cancer: triple negative breast cancer (TNBC) and hormone receptor (HR)-low positive/HER2 negative breast cancer
Product: MK-2870, KEYTRUDA 25 mg/mL concentrate for solution for infusion, MK-2870, PACLITAXEL, CARBOPLATIN, DOXORUBICIN, EPIRUBICIN, CAPECITABINE, CYCLOPHOSPHAMIDE, DEXAMETHASONE

Primary endpoint: Pathological Complete Response (pCR) Rate Using the Definition of ypT0/Tis ypN0, Event-Free Survival (EFS)
Endpoint(s): Overall Survival (OS), pCR-No Ductal Carcinoma in Situ (DCIS) Rate Using the Definition of ypT0 ypN0, pCR (ypT0/Tis ypN0) in Participants with High-Risk, Early-Stage, Triple Negative Breast Cancer (TNBC), EFS in Participants with High-Risk, Early-Stage, TNBC, OS in Participants with High-Risk, Early-Stage, TNBC, Distant Progression or Distant Recurrence-Free Survival (DPDRFS), Change from Baseline in the European Organisation for Research and Treatment of Cancer (EORTC)- Quality of Life Questionnaire-Core 30 (QLQ-C30) Global Health Status/Quality of Life (GHS/QoL) Score, Change from Baseline in EORTC-QLQ-C30 Physical Functioning Score, Change from Baseline in EORTC QLQ-C30 Role Functioning Score, Change from Baseline in EORTC QLQ-C30 Fatigue Score, Change from Baseline in EORTC QLQ-Breast Cancer Questionnaire (BR42) Systemic Therapy Side Effects, Number of Participants with One or More Adverse Events (AEs), Number of Participants Who Discontinue Study Intervention Due to an AE

Source: https://euclinicaltrials.eu/ctis-public/view/2024-520190-12-00